EU clinical trial 2025-522449-23-00: Phase I-IIa, national, multicenter, clinical trial to evaluate the safety and preliminary efficacy of CAR-T CD19 therapy in patients with refractory lupus nephritis.
Protocol code: CART-NEL
Sponsor: Instituto De Investigacion Sanitaria Fundacion Jimenez Diaz (Laboratory/Research/Testing facility). Phase: Phase I and Phase II (Integrated)- Other. Countries: Spain (authorised, recruitment pending).
Therapeutic area(s): Diseases [C] - Immune System Diseases [C20]
Gender: Female, Male. Age: 18-64 years. Enrolment: 10.
Status: Authorised, recruitment pending. Decision date: 2026-06-11. Results received: No. Last updated: 2026-06-11.

Condition(s): Refractory Lupus Nephritis
Product: TranspoCART19

Primary endpoint: To evaluate the safety and tolerability of CD19 CAR‑T cell therapy (TranspoCART19) in patients with refractory lupus nephritis during the early post‑infusion period (Day 0–28; extended to Day +42 in cases of prolonged cytopenias)

Source: https://euclinicaltrials.eu/ctis-public/view/2025-522449-23-00